EU clinical trial 2022-502702-32-00: Bioequivalence of Eltrombopag 75 mg Film-Coated Tablets: A Single-Dose, Open-Label, Randomized, Two-Sequence, Two-Treatment, Two-Period Crossover Study in Healthy Subjects Under Fed Conditions.
Protocol code: BLCL-ELT-FDA-02
Sponsor: Bluepharma Industria Farmaceutica S.A. (Pharmaceutical company). Phase: Human Pharmacology (Phase I)- Bioequivalence Study. Countries: Portugal (ended).
Therapeutic area(s): Diseases [C] - Hemic and Lymphatic Diseases [C15]
Gender: Female, Male. Age: 18-64 years. Enrolment: 72.
Status: Ended. Start date (EU): 2023-05-30. End date (EU): 2023-07-28. Decision date: 2023-03-15. Results received: Yes. Last updated: 2023-07-05.

Condition(s): Aplastic anemia, Thrombocytopenia
Product: Eltrombopag, ELTROMBOPAG OLAMINE

Primary endpoint: The following pharmacokinetic parameters will be estimated: maximum observed plasma concentration (Cmax); time of occurrence of Cmax (Tmax); area under the plasma concentration versus time curve (AUC) from pre-dose (time zero) to 72 hours (AUC0-72); apparent terminal elimination rate constant (λz); and apparent terminal elimination half-life (t1/2).
Endpoint(s): Safety will be evaluated through the assessment of adverse events (AEs), ECG, vital signs, and clinical laboratory tests.

Source: https://euclinicaltrials.eu/ctis-public/view/2022-502702-32-00